EU clinical trial 2024-517416-30-00: A Phase 2 Nonrandomized, Open-label, Multisite Study to Evaluate the Safety and Efficacy of Raludotatug Deruxtecan in Participants With Gastrointestinal Cancers
Protocol code: MK-5909-005
Sponsor: Merck Sharp & Dohme LLC (Pharmaceutical company). Phase: Phase II and Phase III (Integrated). Countries: France (ongoing, recruitment ended), Spain (ongoing, recruitment ended).
Therapeutic area(s): Diseases [C] - Neoplasms [C04]
Gender: Female, Male. Age: 18-64 years, 65+ years. Enrolment: 54.
Status: Ongoing, recruitment ended. Start date (EU): 2025-03-31. Decision date: 2025-03-27. Results received: No. Last updated: 2026-06-26.
Decision dates by country: FR: 2025-03-27, ES: 2025-03-31

Condition(s): Gastrointestinal Cancers
Product: Raludotatug Deruxtecan

Primary endpoint: Objective Response Rate (ORR)
Endpoint(s): Number of Participants who Experience One or More Adverse Events (AEs), Number of Participants who Discontinue Study Treatment due to an AE, Duration of Response (DOR), Progression Free Survival (PFS), Overall Survival (OS)

Source: https://euclinicaltrials.eu/ctis-public/view/2024-517416-30-00